EU clinical trial 2023-509465-20-00: TIming of start of systemIc treatment for asymptomatic MEtastasized PANcreatic cancer (TIMEPAN): a prospective multicenter patient preference cohort
Sponsor: Amsterdam UMC (Hospital/Clinic/Other health care facility). Phase: Therapeutic confirmatory (Phase III). Countries: Netherlands (ongoing, recruiting).
Therapeutic area(s): Diseases [C] - Neoplasms [C04]
Gender: Female, Male. Age: 18-64 years, 65+ years. Enrolment: 184.
Status: Ongoing, recruiting. Start date (EU): 2024-10-28. Decision date: 2024-10-28. Results received: No. Last updated: 2024-10-28.

Condition(s): metastatic pancreatic cancer
Product: Abraxane 5 mg/ml powder for dispersion for infusion., Campto 20 mg/ml, concentraat voor oplossing voor infusie, Gemcitabine Accord 100 mg/ml Concentraat voor Oplossing voor Infusie, 5-Fluorouracil Sandoz 50 mg/ml koncentrátum oldatos infúzióhoz, Oxaliplatine SUN 5 mg/ml, concentraat voor oplossing voor infusie

Primary endpoint: Quality Adjusted Overall Survival
Endpoint(s): Time to disease progression after inclusion (Restricted mean progression free survival (RM-PFS): area under the Kaplan-Meier PFS curve between inclusion and maximum follow-up of the study, estimated 12 months), Quality adjusted Progression Free Survival (PFS), Overall survival (in months), Duration of time without symptoms of disease progression or toxicities (TWiST), Adverse events according to NCI CTC version 5.0, Change in CA 19.9

Source: https://euclinicaltrials.eu/ctis-public/view/2023-509465-20-00